EU clinical trial 2024-513797-22-00: The efficacy of the addition of TRAstuzumab and Pertuzumab to neoadjuvant chemoradiation: a randomized multi-center study in resectable HER2 overexpressing adenocarcinoma of the esophagus or gastroesophageal junction. The TRAP-2 study
Sponsor: Amsterdam UMC Stichting (Hospital/Clinic/Other health care facility). Phase: Therapeutic confirmatory (Phase III). Countries: Netherlands (ongoing, recruiting).
Therapeutic area(s): Diseases [C] - Neoplasms [C04]
Gender: Female, Male. Age: 18-64 years, 65+ years. Enrolment: 408.
Status: Ongoing, recruiting. Start date (EU): 2022-03-09. Decision date: 2024-11-01. Results received: No. Last updated: 2025-08-06.

Condition(s): HER2 positive esophageal adenocarcinoma
Product: Herceptin 150 mg powder for concentrate for solution for infusion, Perjeta 420 mg concentrate for solution for infusion

Primary endpoint: overall survival
Endpoint(s): • Quality-adjusted life years • Progression free survival • Pathological response according to the Mandard criteria • R0 resection rate • Safety in terms of: o Toxicity defined according to CTCAE v5.0 criteria. o Post-operative complications according to the Clavien - Dindo classification. • Percentage completion of chemotherapy and radiation treatment. • Quality of life

Source: https://euclinicaltrials.eu/ctis-public/view/2024-513797-22-00